EU clinical trial 2024-520026-11-00: A Modular Phase I/IIa, Open-label, Multi-center Study to Assess the Safety, Tolerability, Pharmacokinetics, and Preliminary Efficacy of AZD0516 as Monotherapy and in Combination with Anti-cancer Agents in Participants with Metastatic Prostate Cancer.
Protocol code: D9520C00001
Sponsor: AstraZeneca AB (Pharmaceutical company). Phase: Phase I and Phase II (Integrated)- First administration to humans. Countries: Italy (authorised, recruitment pending), Spain (ongoing, recruiting), Poland (authorised, recruitment pending).
Therapeutic area(s): Diseases [C] - Neoplasms [C04]
Gender: Male. Age: 18-64 years, 65+ years. Enrolment: 107.
Start date (EU): 2026-03-19. Decision date: 2025-12-12. Results received: No. Last updated: 2026-04-06.
Decision dates by country: ES: 2025-12-15, IT: 2025-12-12, PL: 2025-12-14

Condition(s): Metastatic Prostate Cancer
Product: AZD0516, AZD9574, AZD9574, AZD9574, AZD9574

Primary endpoint: Dose Escalation (Part A) - Safety: Incidence of AEs, AESIs, SAEs. Incidence of DLTs. Rate of AZD0516 discontinuation due to toxicity. Clinically significant changes from baseline in laboratory parameters, vital signs, ECGs, ECOG performance status, and physical examination., Dose Optimisation (Part B) and Efficacy Expansion (Part C) - Efficacy: PSA50 response rate., Dose Optimisation (Part B) - Safety: Incidence of AEs, AESIs, SAEs. Rate of AZD0516 discontinuation due to toxicity. Clinically significant changes from baseline in laboratory parameters, vital signs, ECGs, ECOG perform.
Endpoint(s): Dose Escalation (Part A) Dose Optimisation (Part B) Efficacy Expansion (Part C)-Efficacy-PSA related endpoints: PSA50 response rate(Part A), PSA90 response rate, Time to PSA50 response, Time to PSA90 response, Duration of PSA50 response, Duration of PSA90 response, Durable PSA50 response rate, Durable PSA90 response rate, Time to PSA progression, and PSA over time., Dose Escalation (Part A) Dose Optimisation (Part B) Efficacy Expansion (Part C)-Efficacy:Radiological response endpoints and estimands, assessed by the investigator evaluated according to RECIST v1.1 (soft tissue) and PCWG3 (bone) criteria: ORR, BOR, DoR, DRR, DCR, TTR, percentage change in tumour size, and rPFS. Other efficacy endpoint: OS, Dose Escalation (Part A) and Dose Optimisation (Part B) - Pharmacokinetics: Plasma concentration of AZD0516, total antibody (conjugated and unconjugated) and total unconjugated warhead. Plasma PK parameters of AZD0516, total antibody (conjugated and unconjugated) and including but not limited to AUC, Cmax, tmax, clearance, and t1/2, as data allow., Dose Escalation (Part A) and Dose Optimisation (Part B) - Biomarker:Target expression via STEAP2 IHC on treatment versus at baseline (in paired biopsy cohorts). Evaluate association of STEAP2 expression with AZD0516 response., Dose Escalation (Part A) and Dose Optimisation (Part B) - Immunogenicity: Evaluate the number and percentage of participants who develop ADA., Efficacy Expansion (Part C) - Safety:Incidence of AEs, AESIs, SAEs. Rate of AZD0516 discontinuation due to toxicity. Clinically significant changes from baseline in laboratory parameters, vital signs, ECGs, ECOG performance status, and physical examination.

Source: https://euclinicaltrials.eu/ctis-public/view/2024-520026-11-00